EU clinical trial 2023-510388-37-00: The effect of suprainguinal fascia iliaca compartment block A healthy volunteer trial
Protocol code: SIFICB
Sponsor: Region Midtjylland (Hospital/Clinic/Other health care facility). Phase: Therapeutic exploratory (Phase II). Countries: Denmark (not authorised).
Therapeutic area(s): Diseases [C] - Musculoskeletal Diseases [C05]
Gender: Female, Male. Age: 18-64 years. Enrolment: 20.
Status: Not authorised. Decision date: 2024-04-16. Results received: No. Last updated: 2024-04-16.

Condition(s): Hip Pain
Product: Ropivacain Fresenius Kabi, Natriumklorid Fresenius Kabi 9 mg/ml , Dotarem, injektionsvæske, opløsning i enkeltdosisbeholder. i.v.

Primary endpoint: The frequency of anesthesia of ON after SOB vs. SIFICB in healthy volunteer subjects. Anesthesia of ON is estimated as significant (≥50 %) reduction of electrical amplitude of EMG signal when measured on the gracilis muscle when comparing values before and after blockade
Endpoint(s): Incidence of spread of injectate to ON after SIFICB estimated by MR-Imaging, Dynamometer muscle strength measurement of adductor and quadriceps muscles after SOB vs. SIFICB, Incidence of cutaneous anesthesia after active SOB, Localization of cutaneous anesthesia after active SOB, Area of cutaneous anesthesia after active SOB

Source: https://euclinicaltrials.eu/ctis-public/view/2023-510388-37-00